EU clinical trial 2023-504301-37-00: A Phase 2b, Randomized, Observer-Blinded Trial to Describe the Safety, Tolerability, and Immunogenicity of MenABCWY Administered on Different Dosing Schedules in Healthy Participants ≥11 to <15 Years of Age
Protocol code: 215344
Sponsor: GlaxoSmithKline Biologicals (Pharmaceutical company). Phase: Therapeutic exploratory (Phase II). Countries: Germany (ongoing, recruitment ended).
Therapeutic area(s): Diseases [C] - Bacterial Infections and Mycoses [C01]
Gender: Female, Male. Age: 0-17 years. Enrolment: 135.
Status: Ongoing, recruitment ended. Start date (EU): 2022-03-03. Decision date: 2023-12-19. Results received: No. Last updated: 2026-07-17.

Condition(s): Meningitis, Meningococcal
Product: NaCl 0.9% solution

Primary endpoint: The percentages of participants with hSBA titers ≥ lower limit of quantitation (LLOQ) for each N. meningitidis serogroup B indicator strains at - baseline (Day 1 [Month 0]) and, - 1 month after the second dose of MenABCWY (Day 751 [Month 25]) for the ABCWY-24 group and Day 1471 [Month 49] for the ABCWY-48 group)., The%of participants with solicited administration site and systemic events during the 7 days following each vaccination at Day 1, Day 721,and Day 1441.The % of participants with any unsolicited AEs including all SAEs, AEs leading to withdrawal,AESIs and medically attended AEs during the 30 days following each vaccination at Day 1,Day 721,and Day 1441.The % of participants with SAEs, AEs leading to withdrawal, AESIs and medically attended AEs during the 6 months following the first vaccination
Endpoint(s): The percentages of participants with hSBA titers ≥ LLOQ for N. meningitidis serogroups A, C, W and Y at - baseline (Day 1 [Month 0]), - 1 month after the first dose of MenABCWY (Day 31 [Month 1]) and, - 1 month after the second dose of MenABCWY (Day 751 [Month 25]) for the ABCWY-24 group and Day 1471 [Month 49] for the ABCWY-48 group).

Source: https://euclinicaltrials.eu/ctis-public/view/2023-504301-37-00